EU clinical trial 2023-509484-24-00: A pivotal, randomized, open-label, two-treatment, two-sequence, four periods, crossover clinical trial to evaluate the bioequivalence of single doses of Test product Sacubitril/Valsartan, film-coated tablets 97 mg/103 mg (Manufacturer: JSC «Farmak», Ukraine) and Reference Entresto®, film-coated tablets 97 mg/103 mg (Novartis Europharm Limited, Ireland) in healthy subjects under fasted conditions
Protocol code: FK/SC-VLS/23
Sponsor: Farmak JSC (Pharmaceutical company). Phase: Human Pharmacology (Phase I)- Bioequivalence Study. Countries: Poland (ended).
Therapeutic area(s): Diseases [C] - Cardiovascular Diseases [C14]
Gender: Female, Male. Age: 18-64 years. Enrolment: 36.
Status: Ended. Start date (EU): 2024-08-10. End date (EU): 2024-09-27. Decision date: 2024-05-06. Results received: No. Last updated: 2024-05-06.

Condition(s): Healthy

Source: https://euclinicaltrials.eu/ctis-public/view/2023-509484-24-00